EU clinical trial 2024-517700-12-00: Adjuvant chemotherapy for prevention of recurrence in patients with detectable ctDNA after surgery in high-riskrectal cancer.
Sponsor: Erasmus Universitair Medisch Centrum Rotterdam (Erasmus MC) (Hospital/Clinic/Other health care facility). Phase: Therapeutic confirmatory (Phase III). Countries: Netherlands (authorised, recruiting).
Therapeutic area(s): Diseases [C] - Digestive System Diseases [C06]; Diseases [C] - Neoplasms [C04]; Analytical, Diagnostic and Therapeutic Techniques and Equipment [E] - Therapeutics [E02]
Gender: Female, Male. Age: 18-64 years, 65+ years. Enrolment: 103.
Status: Authorised, recruiting. Start date (EU): 2025-12-10. Decision date: 2024-10-09. Results received: No. Last updated: 2026-05-28.

Condition(s): Rectal cancer
Product: Folikabi 10 mg/ml oplossing voor injectie/infusie, OXALIPLATIN, CAPECITABINE, FLUOROURACIL

Primary endpoint: disease-free survival in the intention-to-treat population
Endpoint(s): Disease-free survival, Overall survival, Quality of life, In addition to intention-to-treat analysis to estimate the effect size, also a per-protocol analysis (for pure treatment effect) will be carried out for disease-free survival and overall survival, The results of the ctDNA analysis of the blood samples taken at the first follow-up of the randomised patients who were ctDNA positive after surgery will be compared between the patients who received adjuvant chemotherapy and those who did not., Within the group of patients with de-tectable ctDNA after surgery, the pro-portion of patients with detectable ctDNA in the peripheral blood at the timing of detection of recurrent dis-ease on imaging will be assessed.

Source: https://euclinicaltrials.eu/ctis-public/view/2024-517700-12-00